EU clinical trial 2024-520164-33-00: A Multicenter, Open-label, Randomized Phase 3 Study Evaluating THIO Sequenced with Cemiplimab (LIBTAYO®) vs Investigator Choice of Single-agent Chemotherapy as Third-line Treatment in Subjects with Advanced / Metastatic Non-Small Cell Lung Cancer (NSCLC)
Protocol code: THIO-104
Sponsor: Maia Biotechnology Inc. (Pharmaceutical company). Phase: Therapeutic confirmatory (Phase III). Countries: Poland (ongoing, recruiting), Hungary (ongoing, recruiting), Romania (ongoing, recruiting), Spain (authorised, recruitment pending), Portugal (authorised, recruitment pending).
Therapeutic area(s): Diseases [C] - Neoplasms [C04]
Gender: Female, Male. Age: 18-64 years, 65+ years. Enrolment: 130.
Start date (EU): 2025-12-09. Decision date: 2025-09-18. Results received: No. Last updated: 2026-06-15.
Decision dates by country: PL: 2025-09-19, HU: 2025-09-18, RO: 2025-09-19, ES: 2026-06-12, PT: 2026-05-28

Condition(s): Non-Small Cell Lung Cancer
Product: Gemcitabine 1 g Powder for Solution for Infusion, THIO, Vinorelbine 10 mg/ml concentrate for solution for infusion, LIBTAYO 350 mg concentrate for solution for infusion., TAXOTERE 20 mg/0.5 ml concentrate and solvent for solution for infusion

Primary endpoint: OS (defined as the time from randomization to death from any cause)
Endpoint(s): ORR (defined as the proportion of subjects demonstrating a confirmed objective response of CR or PR), DCR (defined as the proportion of subjects demonstrating CR, PR, or SD after 2 treatment cycles), DoR (defined as the time from response [CR/PR] to PD), PFS (defined as the time from randomization to the first occurrence of PD or death from any cause, whichever occurs first), Incidence of TEAEs, SAEs, and TEAEs leading to discontinuation of study medication (THIO and/or cemiplimab) and/or withdrawal from the study

Source: https://euclinicaltrials.eu/ctis-public/view/2024-520164-33-00